EU clinical trial 2022-502547-36-00: An Open-label Study of the Safety, Pharmacokinetics, Efficacy, Pharmacodynamics, and Immunogenicity of Cipaglucosidase Alfa/Miglustat in Pediatric Subjects Aged 0 to < 18 Years with Late-onset Pompe Disease
Protocol code: ATB200-04
Sponsor: Amicus Therapeutics Inc. (Pharmaceutical company). Phase: Therapeutic confirmatory (Phase III). Countries: Italy (ended), Germany (ended).
Therapeutic area(s): Diseases [C] - Nutritional and Metabolic Diseases [C18]
Gender: Female, Male. Age: 0-17 years. Enrolment: 9.
Status: Ended. Start date (EU): 2024-03-21. End date (EU): 2026-04-28. Decision date: 2023-10-24. Results received: No. Last updated: 2025-12-29.
Decision dates by country: IT: 2023-10-24, DE: 2023-10-24

Condition(s): Late-onset Pompe disease
Product: Miglustat Oral Solution 40 mg/mL, AT2221, ATB200

Primary endpoint: 1. Incidence of treatment-emergent AEs, SAEs, IARs, and AEs leading to discontinuation of study drug, 2. Change in anti-rhGAA antibody titers (total and neutralizing) from baseline over time, 3. Change in clinical laboratory test results from baseline over time, 4. Change in vital signs from baseline over time, 5. Change in 12-lead ECG values from baseline over time
Endpoint(s): 1. AUC: area under the plasma drug concentration-time curve, 2. Cmax: maximum observed concentration obtained directly from the concentration profile, 3. (Cohort 1) Change from baseline to Week 52 in the following variables related to ambulatory function: − 6MWD (distance walked, in meters, in the 6MWT) − 6MWD (% predicted), 4. (Cohort 1) Change from baseline to Week 52 in the following variables related to motor function: − total score of the Gait, Stairs, Gowers’ maneuver, and Chair (GSGC) test − time to complete the 10-meter walk (ie, assessment of gait) of the GSGC test − time to complete the 4-stair climb of the GSGC test − time to complete the Gowers’ maneuver of the GSGC test − time to arise from a chair as part of the GSGC test − time to complete the TUG test − total and subdomain scores for the GMFM-88, 5. (Cohort 1) Time to initiation of use of assistive device, 6. (Cohort 1) Change from baseline to Week 52 in the following variables related to muscle strength: − MMT score for the lower and upper extremities − MMT total score, 7. (Cohort 1) Change from baseline to Week 52 in the following measures of pulmonary function: − FVC sitting (% predicted) − SVC sitting (% predicted) − maximal inspiratory pressure (MIP) (cmH2O) − MIP (% predicted) − maximal expiratory pressure (MEP) (cmH2O) − MEP (% predicted) − ventilator use (hours per day), 8. (Cohort 1) Ventilator independence (for non ventilator-dependent subjects only), 9. (Cohort 1) CPAP/BiPAP use, 10. (Cohort 1) Change from baseline to Week 52 in the following variables from PRO measures: − score for NeuroQOL Pediatric Lower Extremity Function (Mobility), 11. (Cohort 1) Actual value of the subject’s functional status (improving, stable, or declining) pertaining to the effects of study drug in the following areas of life, as measured by the SGIC as reported by the subject or subject’s caregiver: − overall physical well-being − effort of breathing − muscle strength − muscle function − ability to move around − activities of daily living − energy level − level of muscular pain, 12. (Cohort 1) Actual value of the subject’s functional status (improving, stable, or declining), as measured by the PGIC, 13. (Cohort 2) Change from baseline to Week 52 in the following variables related to ambulatory function (for subjects ≥ 5 years of age) − 6MWD (distance walked, in meters, in the 6MWT) − 6MWD (% predicted), 14. (Cohort 2) Change from baseline to Week 52 in the following variables related to motor function: − total score for the AIMS (for subjects ≤ 18 months of age) − total and subdomain scores for the GMFM-88 (for subjects ≥ 5 months of age), 15. (Cohort 2) Time to initiation of use of assistive device, 16. (Cohort 2) Change from baseline to Week 52 in the following variables related to muscle strength (for subjects ≥ 4 years of age) − MMT score for the lower and upper extremities and neck − MMT total score, 17. (Cohort 2) Change from baseline to Week 52 in the following measures of pulmonary function (for subjects ≥ 5 years of age): − FVC sitting (% predicted) − SVC sitting (% predicted) − MIP (cmH2O) − MIP (% predicted) − MEP (cmH2O) − MEP (% predicted) − ventilator use (hours per day), 18. (Cohort 2) Ventilator independence (for non-ventilator dependent subjects only), 19. (Cohort 2) CPAP/BiPAP use, 20. (Cohort 2) Change from baseline to Week 52 in the following variables from patient-reported outcomes (PRO) measures: − score for NeuroQOL Pediatric Lower Extremity Function (Mobility), 21. (Cohort 2) Actual value of the subject’s functional status (improving, stable, or declining) pertaining to the effects of study drug in the following areas of life, as measured by the SGIC as reported by the subject or subject’s caregiver: − overall physical well-being − effort of breathing − muscle strength − muscle function − ability to move around − activities of daily living − energy level − level of muscular pain, 22. (Cohort 2) Actual value of the subject’s functional status (improving, stable, or declining), as measured by the PGIC, 23. Change from baseline to Week 52 in the following PD variables: − serum CK level − urinary Hex4 level, 24. Immunogenicity endpoints are as follows for both cohorts: Total and neutralizing anti-rhGAA antibodies

Source: https://euclinicaltrials.eu/ctis-public/view/2022-502547-36-00